EU clinical trial 2024-514677-22-00: Comparison of the effectiveness of IntraVenous FLECainide plus oral ranolazine versus intravenous flecainide alone in the cardioversion of recent onset atrial fibrillation - a randomized, prospective, multicentre, open-label study, the IV-FLEC study.
Sponsor: Win Medica Pharmaceutical A.E. (Pharmaceutical company). Phase: Therapeutic confirmatory (Phase III). Countries: Greece (ended).
Therapeutic area(s): Diseases [C] - Cardiovascular Diseases [C14]
Gender: Female, Male. Age: 18-64 years, 65+ years. Enrolment: 210.
Status: Ended. Start date (EU): 2023-03-23. End date (EU): 2025-05-30. Decision date: 2024-09-09. Results received: Yes. Last updated: 2025-02-11.

Condition(s): Restoration of sinus rhythm in patients with recent AF onset
Product: RANOLAZINE, FLECARDIA Διάλυμα για ένεση/έχχυση

Primary endpoint: Percentage of patients with recent onset (<48 hours) AF who were restored to sinus rhythm within 3 hours of starting treatment with IV flecainide and PO ranolazine compared with IV flecainide monotherapy.
Endpoint(s): Time interval from initiation of treatment with IV flecainide and PO ranolazine versus IV flecainide monotherapy to restoration of sinus rhythm in patients with recent onset (<48 hours) AF, Percentage of patients with recent onset (<48 hours) AF who were restored to sinus rhythm within 6 hours of starting treatment with IV flecainide and PO ranolazine compared with IV flecainide monotherapy.

Source: https://euclinicaltrials.eu/ctis-public/view/2024-514677-22-00